EU clinical trial 2023-503184-42-00: A Randomized, Double-blind, Placebo-controlled Phase 4 Clinical Trial to Evaluate the Long-term Safety and Efficacy of Avacopan in participants With Antineutrophil Cytoplasmic Antibody (ANCA)-associated Vasculitis
Protocol code: 20220159
Sponsor: Amgen Inc. (Pharmaceutical company). Phase: Therapeutic use (Phase IV). Countries: Romania (temporarily halted), Hungary (temporarily halted), Czechia (temporarily halted), Poland (temporarily halted), Denmark (temporarily halted), France (ended), Greece (temporarily halted).
Therapeutic area(s): Diseases [C] - Immune System Diseases [C20]
Gender: Female, Male. Age: 18-64 years, 65+ years. Enrolment: 47.
Start date (EU): 2025-07-28. Decision date: 2024-09-09. Results received: No. Last updated: 2026-06-25.
Decision dates by country: HU: 2024-09-10, RO: 2024-09-11, DK: 2026-03-02, FR: 2026-04-13, GR: 2026-03-09, PL: 2024-09-10, CZ: 2024-09-09

Condition(s): Antineutrophil cytoplasmic antibody-associated vasculitis (AAV)
Product: Tavneos 10 mg hard capsules, AZATHIOPRINE, Placebo for AMG 569, METHOTREXATE, MYCOPHENOLIC ACID, CYCLOPHOSPHAMIDE, RITUXIMAB

Primary endpoint: Evaluation of the overall safety of avacopan, based on reported treatment-emergent adverse events (AEs), AEs of special interest, SAEs, AEs leading to withdrawal, deaths, and changes from baseline vital signs, hematology, serum chemistry, and urinalysis., AEs of special interest include: • Hepatic events and drug-induced liver injury (DILI) • Serious hypersensitivity reactions • Serious infections, Other safety endpoints include: • Infections, based on reported AEs • Creatinine phosphokinase (CPK) increases, based on reported AEs and measured CPK levels • General safety topics including malignancy and major cardiovascular events
Endpoint(s): Time to relapse in AAV between month 12 and month 60 among participants who achieved remission at month 12, in group A compared with group B, • Proportion of participants who relapse after achieving remission at month 12 in group A compared with group B • Proportion of participants who achieved sustained remission at month 60 in group A compared with group C, • Change from baseline to month 60 in: - eGFR of participants with overt renal disease at baseline in group A compared with group C - SF-36 v2 General Health Perception score in group A compared with group C - EQ 5D-5L visual analogue scale in group A compared with group C - Vasculitis damage index (VDI) in group A compared with group C • Proportion of participants who achieved remission at month 6 in groups A + B compared with group C, • Proportion of participants with composite outcome of initiation of maintenance dialysis, kidney transplantation, or death in group A compared with group C from baseline to month 60 • Glucocorticoid use • Immunosuppressant use

Source: https://euclinicaltrials.eu/ctis-public/view/2023-503184-42-00